EU clinical trial 2025-524542-10-00: A Phase 2 Study of ACR-368 Therapy in Subjects with Endometrial Cancer
Protocol code: ACR-368-201
Sponsor: Acrivon Therapeutics Inc. (Pharmaceutical company). Phase: Therapeutic exploratory (Phase II). Countries: Italy (ongoing, recruiting), Germany (authorised, recruitment pending), Spain (ongoing, recruiting), France (ongoing, recruiting).
Therapeutic area(s): Diseases [C] - Neoplasms [C04]
Gender: Female. Age: 18-64 years, 65+ years. Enrolment: 94.
Start date (EU): 2026-04-14. Decision date: 2026-03-23. Results received: No. Last updated: 2026-07-03.
Decision dates by country: FR: 2026-03-25, DE: 2026-03-23, IT: 2026-03-24, ES: 2026-03-27

Condition(s): Endometrial cancer
Product: GEMZAR 200 mg, poudre pour solution pour perfusion, ACR-368

Primary endpoint: Confirmed ORR in subjects per RECIST v1.1 by CT scan and/or MRI.
Endpoint(s): Arm 3 and 4: Incidence of AEs characterized overall and by type, incidence, severity graded according to NCI CTCAE v5.0, seriousness, and relationship to study treatment. Changes in clinical laboratory parameters, vital signs, ECG parameters, and physical examination findings., Arm 3: DOR calculated from the time of first objective response detection according to RECIST v1.1 by CT scan and/or MRI and the time of assessed progressive disease . PFS and OS based on analysis of Kaplan-Meier estimates by CT scans and/or MRI . CBR, i.e., DCR maintained for at least 4 months, by CT scans and/or MRI. Progression-free rate at 6 months and OS at 6, 9, and 12 months, by CT scans and/or MRI., Arm 3 and 4: Confirmed ORR in subjects per RECIST v1.1 by CT scans and/or MRI. DOR calculated from the time of first objective response detection according to RECIST v1.1 by CT scan and/or MRI and the time of assessed progressive disease . CBR, i.e., DCR maintained for at least 4 months, by CT scans and/or MRI. PFS based on analysis of Kaplan-Meier estimates., Arm 3 and 4: Change from Baseline in NRS and FACIT questionnaire scores., Arm 4: DOR calculated from the time of first objective response detection according to RECIST v1.1 by CT scan and/or MRI and the time of assessed progressive disease. PFS and OS based on analysis of Kaplan-Meier estimates. Progression-free rate at 6 months and OS at 6, 9, and 12 months. CBR, i.e., DCR maintained for at least 4 months, by CT scan and/or MRI.

Source: https://euclinicaltrials.eu/ctis-public/view/2025-524542-10-00